EU clinical trial 2023-503554-12-00: CA209-8KX Phase I/II pharmacokinetic multi-tumor study of subcutaneous formulation of nivolumab monotherapy
Protocol code: CA209-8KX
Sponsor: Bristol Myers Squibb International Corporation (Pharmaceutical company). Phase: Phase I and Phase II (Integrated)- Other. Countries: Spain (ended), Netherlands (ended), Italy (ended), Poland (ended), France (ended).
Therapeutic area(s): Diseases [C] - Neoplasms [C04]
Gender: Female, Male. Age: 18-64 years, 65+ years. Enrolment: 96.
Status: Ended. Start date (EU): 2019-01-09. End date (EU): 2024-09-12. End date: 2024-09-13. Decision date: 2023-06-23. Results received: Yes. Last updated: 2024-07-19.
Decision dates by country: IT: 2023-08-07, ES: 2023-07-26, NL: 2023-06-23, PL: 2023-08-08, FR: 2023-09-04

Condition(s): lung cancer; kidney cancer; melanoma; liver cancer; colorectal cancer; bladder cancer
Product: Nivolumab Subcutaneous, Nivolumab Subcutaneous, MDX1106 ONO-4538, MDX1106 ONO-4538, OPDIVO 10 mg/mL concentrate for solution for infusion., OPDIVO 10 mg/mL concentrate for solution for infusion.

Primary endpoint: Serum nivolumab Parts A, B, D, and E: -Cmax (Maximal concentration) -Tmax (Time to maximal concentration) -AUC(TAU)(Area under the concentration-time curve over the dosing interval) -Ctau (observed serum nivolumab concentration at the end of the dosing interval), Serum nivolumab Part C: -Ctrough (trough observed serum nivolumab concentration)
Endpoint(s): - Incidences of AEs, TRAEs, SAEs, TRSAEs, AEs/TRAEs leading to discontinuation, deaths, and laboratory abnormalities, - Incidence of AEs in the MedDRA Anaphylactic Reaction broad scope SMQ occurring within 2 days after study drug administration, - Incidence of events within the hypersensitivity/infusion reaction select AE category occurring within 2 days after any study drug administration., - Incidence of anti-nivolumab antibodies and neutralizing antibodies, if applicable

Source: https://euclinicaltrials.eu/ctis-public/view/2023-503554-12-00